EU clinical trial 2024-512975-11-01: Avelumab Short Maintenance Trial
Protocol code: NL75848.056.20
Sponsor: Erasmus Universitair Medisch Centrum Rotterdam (Erasmus MC) (Hospital/Clinic/Other health care facility). Phase: Phase III and phase IV (Integrated). Countries: Netherlands (authorised, recruitment pending).
Therapeutic area(s): Diseases [C] - Neoplasms [C04]
Gender: Female, Male. Age: 18-64 years, 65+ years. Enrolment: 121.
Status: Authorised, recruitment pending. Decision date: 2025-01-28. Results received: No. Last updated: 2026-03-06.

Condition(s): urothelial cancer, Bladder cancer, muscle invasive bladder cancer
Product: Bavencio 20 mg/mL concentrate for solution for infusion

Primary endpoint: 18months overallsurvival (OS)
Endpoint(s): OS in PD-L1 positive and PD-L1 negative tumors, in patients with visceral versus non-visceral metastases, in patients with CR/PR as best response to chemotherapy versus SD, and in retreated patients. PFS in PD-L1 positive and PD-L1 negative tumors, and in retreated patients. ORR per RECIST 1.1 in retreated patients. Duration ofresponse. Disease control (defined as complete response, partial response, non—complete response or non-progressive disease, orstable disease at 24 weeks after initi

Source: https://euclinicaltrials.eu/ctis-public/view/2024-512975-11-01